EU clinical trial 2023-503480-42-00: Baricitinib for treating hospital-acquired pneumonia in critically ill patients with a proinflammatory phenotype, an international phase II / phase III, randomized, controlled trial - the TREAT-HAP study.
Protocol code: RC22_0522
Sponsor: Centre Hospitalier Universitaire De Nantes (Hospital/Clinic/Other health care facility). Phase: Phase II and Phase III (Integrated). Countries: Spain (not authorised), France (not authorised), Belgium (not authorised), Netherlands (not authorised).
Therapeutic area(s): Diseases [C] - Bacterial Infections and Mycoses [C01]
Gender: Female, Male. Age: 18-64 years, 65+ years. Enrolment: 450.
Status: Not authorised. Decision date: 2023-07-03. Results received: No. Last updated: 2023-07-03.
Decision dates by country: BE: 2023-07-03, FR: 2023-07-03, ES: 2023-07-03, NL: 2023-07-03

Condition(s): Hospital-acquired pneumonia
Product: Olumiant 2 mg film-coated tablets, Olumiant 4 mg film-coated tablets

Primary endpoint: The co-primary hierarchic endpoints to demonstrate the efficacy of baricitinib plus standard of care (SOC) compared to SOC for the treatment of hospital-acquired pneumonia will be a clinical cure at the test-of-cure (TOC) visit and all-cause mortality at Day 28.
Endpoint(s): In case of non-significative difference in the rate of clinical cure, the co-primary outcome (all-cause mortality at Day 28) will be presented as a secondary outcome, The secondary outcomes to determine the safety of baricitinib are rate of serious adverse effects and suspected unexpected serious adverse reaction (SUSAR) at Day 28, The secondary outcomes to determine if baricitinib increases the economic efficiency of the treatment of pneumonia are the economic endpoints at 6 months, Incremental cost-effectiveness ratio (ICER)., The secondary outcomes to determine the suitability and acceptability of baricitinib from the patients’ perspectives are changes in health-related quality of life (HRQoL) from three (M3) to six months (M6) after randomization measured with SF-36, HADS and SWLS.

Source: https://euclinicaltrials.eu/ctis-public/view/2023-503480-42-00